EU clinical trial 2023-510358-17-00: Impact of Tight blood Glucose Control within normal fasting ranges with insulin titration prescribed by the Leuven algorithm in adult critically ill patients.
Sponsor: UZ Leuven (Hospital/Clinic/Other health care facility). Phase: Therapeutic confirmatory (Phase III). Countries: Belgium (ongoing, recruitment ended).
Therapeutic area(s): Diseases [C] - Nutritional and Metabolic Diseases [C18]
Gender: Female, Male. Age: 18-64 years, 65+ years. Enrolment: 9230.
Status: Ongoing, recruitment ended. Start date (EU): 2018-09-01. Decision date: 2024-10-02. Results received: No. Last updated: 2024-10-02.

Condition(s): Hyperglycemia in critically ill patients (stress hyperglycemia)
Product: INSULIN (HUMAN)

Primary endpoint: The duration of ICU dependency (defined as the crude number of days with need for vital organ support and as the time to live discharge from ICU to account for death as competing risk)
Endpoint(s): Glucose metrics in ICU, with and without censoring at 90 days (mean/median morning blood glucose concentration, mean daily blood glucose concentration, incidence of moderate and severe hypoglycemia during ICU stay, peak blood glucose concentration after hypoglycemic event, duration of hypoglycemia, number of hypoglycemic events per patient, minimum and maximum blood glucose concentration per day, time within blood glucose target range, blood glucose variability, hyperglycemic index), Mortality in ICU and in hospital, with and without censoring at 90 days, Mortality 90 days post randomization, Hospital length of stay, with and without censoring at 90 days, Time to (live) discharge from hospital, with and without censoring at 90 days, Time to final (live) weaning from mechanical respiratory support, with and without censoring at 90 days, The duration of ICU dependency (defined as the crude number of days with need for vital organ support and as the time to live discharge from ICU to account for death as competing risk), with censoring at 90 days, The incidence of new infections during ICU stay, with and without censoring at 90 days, The need for tracheostomy during ICU stay, with and without censoring at 90 days, Presence of clinical, electrophysiological and morphological signs of respiratory and peripheral muscle weakness during ICU stay in patient subgroups in selected centers, with and without censoring at 90 days, The presence or absence of new kidney injury during ICU stay, and duration and recovery herefrom, with and without censoring at 90 days, The need for new initiation of renal replacement therapy in ICU (incidence, duration and recovery hereof), with and without censoring at 90 days, The need for hemodynamic support during ICU stay, its duration and the time to (live) weaning from hemodynamic support, with and without censoring at 90 days, The incidence of new-onset atrial fibrillation and recurrence of pre-existing atrial fibrillation during ICU stay in selected centers, with and without censoring at 90 days, The incidence of major adverse cardiovascular events (MACE; non-fatal myocardial infarction, non-fatal stroke, low cardiac output syndrome, and cardiovascular death) during ICU stay in selected centers, with and without censoring at 90 days, The presence or absence of signs of liver dysfunction in ICU, with and without censoring at 90 days, The duration of antibiotic treatment during ICU stay, with and without censoring at 90 days, The incidence of bacteremia, and of airway, urinary tract, wound and other infections acquired during ICU stay, with and without censoring at 90 days, Peak and time profile of C-reactive protein concentrations during ICU stay, with and without censoring at 90 days, The number of readmissions to the ICU within 48 hours after discharge, with and without censoring at 90 days, The presence or absence of delirium during ICU stay (in selected centers), with and without censoring at 90 days, Biochemical, metabolic, immunological, inflammatory, cardiac and (epi)genetic markers on blood and tissue samples up to 5 years post randomization (depending on additional funding and in selected centers), Muscle strength, rehabilitation, recovery of organ function and survival up to 5 years post randomization in selected centers and subgroups of patients (depending on additional funding), Long-term functional outcome: For all patients: a validated health questionnaire (Short Form 36, SF-36) 2 years after inclusion, Subgroup of brain-injured patients: additional functional outcome after 6 and 12 months (extended Glasgow outcome scale and/or modified Rankin scale), Survival and Barthel index (index obtained by verbal questionnaire) up to 5 years post randomization, in selected centers, Use of intensive care resources (costs for hospitalization, for honoraria for medical and allied healthcare services, for pharmacy, for blood products, for clinical chemistry, for radiology, for graft products and for other expenses), The presence or absence of new-onset diabetes mellitus diagnosed after enrolment in the study, up to 5 years post randomization, and, if applicable, the timing of diagnosis and current treatment (e.g. diet only, antidiabetic drugs, insulin or other parenteral treatment), in selected centers, The presence or absence of pancreas or pancreatic islet transplantation, up to 5 years post randomization, and, if applicable, the timing of transplantation, in selected centers, The presence or absence of end stage renal disease (ESRD) treated with maintenance renal replacement therapy (RRT) or kidney transplantation, at up to 5 years post randomization, and, if applicable, the timing of initiation and the modality of RRT (in-center hemodialysis, home hemodialysis or peritoneal dialysis), in selected centers

Source: https://euclinicaltrials.eu/ctis-public/view/2023-510358-17-00